EU clinical trial 2024-516549-37-00: A randomized double-blind placebo-controlled multicentre study to assess safety, tolerability, pharmacokinetics and efficacy of Radotinib in Parkinson’s disease.
Protocol code: RT51EP1902
Sponsor: Il-Yang Pharm Co. Ltd. (Pharmaceutical company). Phase: Therapeutic exploratory (Phase II). Countries: France (ongoing, recruitment ended).
Therapeutic area(s): Psychiatry and Psychology [F] - Mental Disorders [F03]
Gender: Female, Male. Age: 18-64 years, 65+ years. Enrolment: 40.
Status: Ongoing, recruitment ended. Start date (EU): 2021-04-12. Decision date: 2024-08-20. Results received: No. Last updated: 2026-07-31.

Condition(s): Treatment of Parkinson’s disease (PD)
Product: Radotinib HCl, Placebo for Radotinib HCl

Primary endpoint: Evaluation of safety parameters (AE, vital signs, 12-lead ECG, laboratory parameters, physical exams).
Endpoint(s): Pharmacokinetics assessments of Radotinib HCl: Cmax, Tmax, Ctrough, AUCt, AUCinf, AUC0-12h, Kel, t1/2, %AUCextra, Vd/F, CL/F, R., Change from Baseline in the sum of MDS-UPDRS Parts I, II and III after 24 weeks of treatment., Time from baseline to initiation of dopamine-replacement medication., Change in health related quality of life as measured by a quality of life questionnaire (PDQ-39)., Subject's clinical global impression of change.

Source: https://euclinicaltrials.eu/ctis-public/view/2024-516549-37-00